EU clinical trial 2023-508428-36-00: CBD, amitriptyline and tramadol drug-drug interaction study
Protocol code: CHDR2335
Sponsor: Centre for Human Drug Research (Laboratory/Research/Testing facility). Phase: Therapeutic exploratory (Phase II). Countries: Netherlands (ended).
Therapeutic area(s): Phenomena and Processes [G] - Metabolism [G03]
Gender: Female, Male. Age: 18-64 years. Enrolment: 12.
Status: Ended. Start date (EU): 2023-12-19. End date (EU): 2024-03-12. Decision date: 2023-12-14. Results received: No. Last updated: 2024-01-30.

Condition(s): Neurological assessments

Source: https://euclinicaltrials.eu/ctis-public/view/2023-508428-36-00